EU clinical trial 2024-516898-72-00: Neoadjuvant gemcitabine and cisplatin in combination with perioperative pembrolizumab versus upfront surgery for patients with primary resectable and borderline resectable perihilar and distal cholangiocarcinoma (NEODISCO): A Multicentre Phase 2B/3 Randomised Controlled Trial
Sponsor: Stichting Amsterdam UMC (Hospital/Clinic/Other health care facility). Phase: Phase II and Phase III (Integrated). Countries: Netherlands (ongoing, recruiting).
Therapeutic area(s): Diseases [C] - Neoplasms [C04]
Gender: Female, Male. Age: 18-64 years, 65+ years. Enrolment: 5.
Status: Ongoing, recruiting. Start date (EU): 2026-04-17. Decision date: 2025-11-21. Results received: No. Last updated: 2025-11-21.

Condition(s): Perihilar cholangiocarcinoma, distal cholangiocarcinoma
Product: GEMCITABINE, CISPLATIN, PEMBROLIZUMAB

Primary endpoint: Event free survival
Endpoint(s): Overall survival, Locoregional failure free interval, Distant metastasis-free interval, Resection rate, Radical resection rate, Postoperative complications (30 and 90 days), Postoperative moratlity (30 and 90 days), (Serious) adverse events, Toxicity (CTCAE V5.0), QoL: EORTC QLQ-C30, QoL: EQ-5D, Clinical response rate (using RECIST), Lymf node status: nodes 8, 9, 12A and 12P will be resected and examined by the pathologist to determine the N status., Serum CA 19-9 and CEA response: defined as the change in CA 19-9 levels after 3 and 6 cycles neoadjuvant, and during follow up after surgery, relative to baseline, Pathologic complete and partial response: assessed using the CAP (College of American Pathologists) pancreas protocol., Expression of biomarkers: including but not limited to analysis of circulation tumor DNA

Source: https://euclinicaltrials.eu/ctis-public/view/2024-516898-72-00